EU clinical trial 2024-511231-94-00: Prospective, open-label, single-arm, multicentre Phase 3 study to evaluate the pharmacokinetics, efficacy, tolerability, and safety of subcutaneous human immunoglobulin (Newnorm) in patients with primary immunodeficiency diseases
Protocol code: NORM-01
Sponsor: Octapharma Pharmazeutika Produktionsgesellschaft mbH (Pharmaceutical company). Phase: Therapeutic confirmatory (Phase III). Countries: Italy (ended), Slovakia (ended), Hungary (ended), Poland (ended), Germany (ended).
Therapeutic area(s): Phenomena and Processes [G] - Immune system processes [G12]
Gender: Female, Male. Age: 0-17 years, 18-64 years, 65+ years. Enrolment: 50.
Status: Ended. Start date (EU): 2021-10-27. End date (EU): 2026-03-09. Decision date: 2024-07-12. Results received: No. Last updated: 2025-10-14.
Decision dates by country: IT: 2024-07-17, SK: 2024-07-12, DE: 2024-07-19, PL: 2024-08-04, HU: 2024-07-15

Condition(s): Human Normal Immunoglobulin
Product: Newnorm

Primary endpoint: The primary endpoint of this study is the rate of SBIs (defined as bacteraemia/sepsis, bacterial meningitis, osteomyelitis/septic arthritis, bacterial pneumonia, and visceral abscess) per person-year on treatment. The primary efficacy endpoint will be analysed for the 52-week efficacy period. The primary PK endpoint is the average total IgG concentration (Cav) on steadystate dosing.
Endpoint(s): Infections of any type or seriousness (including acute sinusitis, exacerbation of chronic sinusitis, acute otitis media, acute bronchitis, infectious diarrhoea, etc) (total and by category, annual rate), Time to resolution of infections, Use of antibiotics (number of days on antibiotics and annual rate of treatment episodes) characterised as therapeutic or prophylactic use, Hospitalisations due to infection (number of days and annual rate), Episodes of fever, Days lost from work, school, kindergarten, or day care due to infection, QoL assessments using the Child Health Questionnaire-Parent Form (CHQPF50) for patients <14 years and the SF-36 Health Survey for patients ≥14 years of age

Source: https://euclinicaltrials.eu/ctis-public/view/2024-511231-94-00